EU clinical trial 2024-511526-31-00: A randomized, open-label, single dose, 2-way crossover bioequivalence study comparing apixaban 5 mg hard capsules (PG412 [Celon Pharma]) vs apixaban 5 mg film-coated tablets (Eliquis [Bristol-Myers Squibb]) under fasting conditions in healthy volunteers
Protocol code: 01API2024
Sponsor: Celon Pharma S.A. (Pharmaceutical company). Phase: Human Pharmacology (Phase I)- Bioequivalence Study. Countries: Poland (ended).
Therapeutic area(s): Diseases [C] - Cardiovascular Diseases [C14]
Gender: Female, Male. Age: 18-64 years. Enrolment: 38.
Status: Ended. Start date (EU): 2024-08-20. End date (EU): 2024-10-21. Decision date: 2024-08-13. Results received: No. Last updated: 2024-08-13.

Condition(s): Prevention of stroke and systemic embolism in adult patients with non-valvular atrial fibrillation (NVAF), with one or more risk factors, such as prior stroke or transient ischaemic attack (TIA); age≥ 75 years; hypertension; diabetes mellitus; symptomatic heart failure (NYHA Class ≥ II). Treatment of deep vein thrombosis (DVT) and pulmonary embolism (PE), and prevention of recurrent DVT and PE in adults.

Source: https://euclinicaltrials.eu/ctis-public/view/2024-511526-31-00